EU clinical trial 2024-513199-16-00: A Phase 1 Study of JNJ-89853413 for Relapsed or Refractory Acute Myeloid Leukemia or Myelodysplastic Neoplasms
Protocol code: 89853413AML1001
Sponsor: Janssen Cilag International (Pharmaceutical company). Phase: Human Pharmacology (Phase I)- First administration to humans. Countries: Spain (ongoing, recruiting).
Therapeutic area(s): Diseases [C] - Neoplasms [C04]
Gender: Female, Male. Age: 18-64 years, 65+ years. Enrolment: 20.
Status: Ongoing, recruiting. Start date (EU): 2025-02-04. Decision date: 2025-01-20. Results received: No. Last updated: 2026-02-03.

Condition(s): Relapsed or Refractory Acute Myeloid Leukemia or Relapsed or Refractory Higher-risk Types of Myelodysplastic Neoplasms

Source: https://euclinicaltrials.eu/ctis-public/view/2024-513199-16-00